EU clinical trial 2025-521354-42-00: A randomized, double-blind crossover study to investigate the analgesic efficacy of the bradykinin (B2) antagonist icatibant for propofol injection pain in healthy adult participants.
Protocol code: PIP-Icat
Sponsor: Oslo University Hospital HF (Hospital/Clinic/Other health care facility). Phase: Therapeutic exploratory (Phase II). Countries: Norway (authorised, recruitment pending).
Therapeutic area(s): Diseases [C] - Nervous System Diseases [C10]; Analytical, Diagnostic and Therapeutic Techniques and Equipment [E] - Therapeutics [E02]; Analytical, Diagnostic and Therapeutic Techniques and Equipment [E] - Anesthesia and Analgesia [E03]
Gender: Female, Male. Age: 18-64 years. Enrolment: 26.
Status: Authorised, recruitment pending. Decision date: 2025-08-14. Results received: No. Last updated: 2025-08-14.

Condition(s): Pain
Product: Propolipid, Natriumklorid ”B. Braun”, infusionsvæske, opløsning, ICATIBANT

Primary endpoint: Area under the curve of Visual Analog Scale pain ≥ 30 mm (0-100 mm) - AUCVAS≥30
Endpoint(s): Max electronic Visual Analog Scale (VAS) pain (0-100 mm)

Source: https://euclinicaltrials.eu/ctis-public/view/2025-521354-42-00